EU clinical trial 2024-519573-19-00: NEOSTART Study - NEOADJUVANT PEMBROLIZUMAB IN PATIENTS WITH HIGH RISK, STAGE IIB/IIC CUTANEOUS MELANOMA: A SINGLE ARM PROOF OF CONCEPT PHASE IIA STUDY
Protocol code: 2024/880
Sponsor: Centre Hospitalier Regional Universitaire (Hospital/Clinic/Other health care facility). Phase: Therapeutic exploratory (Phase II). Countries: France (authorised, recruitment pending).
Therapeutic area(s): Diseases [C] - Skin and Connective Tissue Diseases [C17]
Gender: Female, Male. Age: 18-64 years, 65+ years. Enrolment: 19.
Status: Authorised, recruitment pending. Decision date: 2025-09-02. Results received: No. Last updated: 2026-06-10.

Condition(s): melanoma
Product: KEYTRUDA 25 mg/mL concentrate for solution for infusion

Primary endpoint: The Major Pathological Response (MPR) on the primary tumour surgical specimen in accordance with International Neoadjuvant Melanoma Consortium criteria [(Tetzlaff et al. 2018; Amaria et al. 2019) including complete response (absence of viable tumour cells) and near-complete response (<10% tumoral viable cells)]
Endpoint(s): Toxicities: incidence and grade for Adverse events (AEs), drug related AEs, drug related AE leading to discontinuation during neoadjuvant treatment, surgery related AEs, surgery related AE leading to delayed or cancellation of adjuvant treatment, SAE and SUSAR, according to NCI-CTCAE V5.0 until the end of treatment visit, The Major Pathological Response (MPR) on the primary tumor surgical specimen in accordance with International Neoadjuvant Melanoma Consortium criteria [(Tetzlaff et al. 2018) including complete response (absence of viable tumor cells) and near-complete response (<10% tumoral viable cells)], The proportion of patients undergoing a sentinel lymph node (SLN) biopsy who have a positive result in the SLN, The number of SLN identified and the number harvested, The proportion of patients with positive SLN who undergo complete lymph node dissection., The number of patients who complete in totality the neoadjuvant treatment, who undergo surgery and who start the adjuvant therapy divided by the number of patients who initiated the neoadjuvant treatment, The rate of patient included divided by the number of patients screened., Clinical response will be systematically assessed using clinical examination with standardized photographs of the primary tumor as the primary tumor will not be measured by CT scan. Complete response is defined as the disappearance of the lesion. Partial response is defined as the decrease in size of the lesion. Progression is defined as an increase in size of the lesion (>25% with at least 2 mm increase in size for lesion below 1cm)., Event-free survival (EFS) defined as the time from neoadjuvant treatment initiation to the first of the following events: death of all causes, melanoma progression prior planned surgery leading to stage 3 or 4 disease or leading to unresectable disease, toxicity during the neoadjuvant treatment that preclude the surgery, local or distant recurrence after surgery, whichever occurred first. Patients with no defined events observed during the follow-up will be censored at the date of last disease e, Relapse-free survival (RFS) after surgery defined as the time from surgery to relapse or death, whichever occurred first. Secondary melanoma cancers will not be regarded as RFS events, nonmelanoma cancers will be disregarded in the analysis. Data for patients lost to follow-up will be censored, Distant metastasis-free survival (DMFS) as the time from surgery to relapse with distant metastasis or death, whichever occurred first. Data for patients lost to follow-up will be censored, Overall Survival (OS): defined as the time from the neoadjuvant treatment initiation to death from any cause. Alive patient will be censored at last date known to be alive either during study treatment period or during follow-up period, ORR, SLN positivity, EFS, RFS, DMFS, OS, Health-related quality of life measures by EORTC-QLQ C30 questionnaire

Source: https://euclinicaltrials.eu/ctis-public/view/2024-519573-19-00